EU clinical trial 2024-515510-41-00: Phase II Randomized Controlled Study Aiming to Evaluate the Interest of Qutenza in Patients With ORL Cancer in Remission and With Sequellae Neuropathic Pain.
Protocol code: 20 VADS 04
Sponsor: Oncopole Claudius Regaud (Hospital/Clinic/Other health care facility). Phase: Therapeutic exploratory (Phase II). Countries: France (ended).
Therapeutic area(s): Diseases [C] - Neoplasms [C04]
Gender: Female, Male. Age: 18-64 years, 65+ years. Enrolment: 130.
Status: Ended. Start date (EU): 2021-04-28. End date (EU): 2025-04-28. Decision date: 2024-08-13. Results received: Yes. Last updated: 2024-08-13.

Condition(s): Head and neck cancer
Product: Laroxyl 40 mg/mL, solution buvable, Qutenza 179 mg cutaneous patch

Primary endpoint: The Primary Outcome Measure is the rate of patients with a decrease in average pain over the last 24 hours by 2 points at 9 months compared to inclusion.
Endpoint(s): For the sensitivity analysis, the endpoint will be defined as the rate of patients with a decrease in average pain over the last 24 hours by 2 points at 9 months compared to inclusion. Pain will be assessed using a numerical scale. Patients for whom pain management would be modified from the protocol will be considered failures. Patients with missing data for pain progression will be considered failures., Neuropathic pain will be assessed using the Neuropathic Pain Symptom Inventory (NPSI) self-questionnaire developed and validated in French (Bouhassira, Pain 2014)., Adverse drug reactions (capsaicin and amitriptyline) will be assessed using the NCI-CTC AE V5., Quality of life will be assessed using the EORTC QLQ-C30 questionnaire.

Source: https://euclinicaltrials.eu/ctis-public/view/2024-515510-41-00